EU clinical trial 2023-507303-55-00: I5T-MC-AACI: Assessment of Safety, Tolerability, and Efficacy of Donanemab in Early Symptomatic Alzheimer's Disease
Protocol code: I5T-MC-AACI
Sponsor: Eli Lilly & Co. (Pharmaceutical company). Phase: Therapeutic exploratory (Phase II). Countries: Netherlands (ended), Czechia (ended), Poland (ended).
Therapeutic area(s): Diseases [C] - Nervous System Diseases [C10]
Gender: Female, Male. Age: 18-64 years, 65+ years. Enrolment: 224.
Status: Ended. Start date (EU): 2020-09-30. End date (EU): 2025-09-17. Decision date: 2024-10-01. Results received: No. Last updated: 2025-01-23.
Decision dates by country: CZ: 2024-10-02, NL: 2024-10-01, PL: 2024-10-09

Condition(s): Alzheimer Disease
Product: FLORBETAPIR, Placebo to match LY, Flortaucipir, Donanemab

Primary endpoint: Change From Baseline on the Integrated Alzheimer's Disease Rating Scale (iADRS) (Overall Population).

Source: https://euclinicaltrials.eu/ctis-public/view/2023-507303-55-00